EU clinical trial 2023-506628-98-00: Evaluation of the efficacy and safety of dual biologic and/or small molecule therapy in patients with induction-resistant ulcerative colitis (RESPECT).
Protocol code: ABM/RESPECT/2023
Sponsor: Wojskowy Instytut Medyczny Panstwowy Instytut Badawczy (Hospital/Clinic/Other health care facility). Phase: Therapeutic exploratory (Phase II). Countries: Poland (ongoing, recruiting).
Therapeutic area(s): Diseases [C] - Digestive System Diseases [C06]; Diseases [C] - Immune System Diseases [C20]
Gender: Female, Male. Age: 18-64 years, 65+ years. Enrolment: 180.
Status: Ongoing, recruiting. Start date (EU): 2025-05-27. Decision date: 2024-05-07. Results received: No. Last updated: 2026-07-10.

Condition(s): Ulcerative colitis
Product: TOFACITINIB, TOFACITINIB, INFLIXIMAB, TOFACITINIB, TOFACITINIB, INFLIXIMAB, VEDOLIZUMAB

Primary endpoint: Percentage of sustained corticosteroid-free remissions at week 52, sustained from week 8 onward with a maximum 11-week regimen of corticosteroids tapering. Clinical remission defined as the total Mayo score of ≤ 2 with all subscores of ≤ 1 and Mayo rectal bleeding subscore of 0
Endpoint(s): Percentage of clinical response at Week 8, Week 22 and Week 52, defined as a decrease in the total Mayop score of at least 3 points and at least 30% from the baseline value, with an accompanying decrease in the rectal bleeding subscore of at least 1 point or an absolute rectal bleeding subscore of 0 or 1., Percentage of clinical remission at Week 8, defined as the total Mayo score of ≤ 2 with all subscores of ≤ 1 and Mayo rectal bleeding subscore of 0., Percentage of deaths from ulcerative colitis at Week 8, Week 22, and Week 52., The cumulative dose of corticosteroids used during the current flare of ulcerative colitis at Week 52., Percentage of patients who achieved mucosal healing at Week 8, Week 22, and Week 52, defined as the Mayo Endoscopic Score of ≤ 1., Percentage of patients who achieved histologic – endoscopic mucosal healing at Week 8, Week 22, and Week 52, defined as achieving a combination of histologic remission and mucosal healing, as defined below: - histologic remission, defined as an absolute Robarts Histopathological Index (RHI) score of 3 points or less - mucosal healing, defined as the Mayo Endoscopic Score of ≤ 1., Percentage of patients who achieved deep histologic – endoscopic mucosal healing at Week 8, Week 22, and Week 52, defined as achieving a combination of histologic remission and endoscopic normalization, as defined below: - histologic remission, defined as an absolute Robarts Histopathological Index (RHI) score of 3 points or less - endoscopic normalization, defined as the Mayo Endoscopic Score of 0., Change from baseline value in quality of life measured by SIBDQ, PROMIS-29 v.2.1, WPAI:GH v.2.2 and PSQI questionnaires, at Week 8, Week 22, and Week 52., Occurrence of severe adverse events at Week 8, Week 22, and Week 52., Occurrence of non-severe adverse events at Week 8, Week 22, and Week 52., Occurrence of death from any cause at Week 8, Week 22, and Week 52., Occurrence of MACE events, defined as cardiovascular death, non-fatal myocardial infarction, or non-fatal stroke, at Week 8, Week 22, and Week 52., Occurrence of tuberculosis at Week 8, Week 22, and Week 52., Occurrence of hemiplegia at Week 8, Week 22, and Week 52.

Source: https://euclinicaltrials.eu/ctis-public/view/2023-506628-98-00